EU clinical trial 2023-507217-10-00: A randomized, double-masked, placebo-controlled safety, tolerability, and efficacy study of VRDN-001, a humanized monoclonal antibody directed against the IGF-1 receptor, in participants with chronic thyroid eye disease (TED)
Protocol code: VRDN-001-301
Sponsor: Viridian Therapeutics Inc. (Pharmaceutical company). Phase: Therapeutic confirmatory (Phase III). Countries: Spain (ended), Hungary (ended), Poland (ended), France (ended), Italy (ended), Germany (ended).
Therapeutic area(s): Diseases [C] - Eye Diseases [C11]
Gender: Female, Male. Age: 18-64 years, 65+ years. Enrolment: 170.
Status: Ended. Start date (EU): 2024-04-12. End date (EU): 2025-07-18. End date: 2025-07-25. Decision date: 2024-04-02. Results received: Yes. Last updated: 2025-09-03.
Decision dates by country: PL: 2024-04-04, HU: 2024-04-02, IT: 2024-04-04, DE: 2024-04-04, FR: 2024-04-02, ES: 2024-04-02

Condition(s): Thyroid eye disease
Product: SODIUM CHLORIDE, VRDN-001 (Insulin-like growth factor-1 receptor [IGF-1R] inhibitor)

Primary endpoint: Overall Response Rate comprised of Proptosis Responder Rate in the most proptotic eye at 3 weeks post the fifth IV infusion and Clinical Activity Responder Rate in the most proptotic eye at 3 weeks post the fifth IV infusion., Safety Endpoint: Adverse Events (AEs) and Serious Adverse Events (SAEs) will be monitored and recorded throughout the duration of the study. All clinically significant changes in other safety measurements will be recorded as AEs.
Endpoint(s): Change from baseline in proptosis for the most proptotic eye at Week 15., Proptosis change from baseline, general and measured by exophtalmometer and responder rate at Week 15., Diplopia Responder and Resolution Rate (i.e., reduction in Diplopia Score to 0 from baseline for participants with baseline Diplopia Score >0) at Week 15.

Source: https://euclinicaltrials.eu/ctis-public/view/2023-507217-10-00